EU clinical trial 2024-518795-31-00: Pilot study of the pharmacokinetic profile of paracetamol subcutaneously versus intravenously in patients in a palliative situation
Protocol code: 17-245
Sponsor: Centre Hospitalier Universitaire De Caen Normandie (Hospital/Clinic/Other health care facility). Phase: Phase II and Phase III (Integrated). Countries: France (authorised, recruitment pending).
Therapeutic area(s): Not possible to specify
Gender: Female, Male. Age: 18-64 years, 65+ years. Enrolment: 12.
Status: Authorised, recruitment pending. Decision date: 2024-10-28. Results received: No. Last updated: 2025-12-22.

Condition(s): Adult patients (> 18 years of age) undergoing palliative care (defined by the WHO as active, comprehensive care given to patients whose condition does not respond to curative treatment) of their disease, able to communicate, and with a functional central venous line with reflux, presenting spontaneous pain with a numerical scale greater than 3 or paracetamol as part of their usual treatment.
Product: PARACETAMOL B BRAUN 10 mg/ml, solution pour perfusion

Primary endpoint: - Measurement of paracetamolemia to determine AUC0-t, AUC0-∞, Cmax , Vd and t1/2 for each mode of administration for the same patient, and generation of pharmacokinetic curves.
Endpoint(s): - Pain assessment using a digital scale, - Skin monitoring and tolerance assessment throughout administration and protocol completion (D0 to D30), - Safety criterion: systematic collection of adverse events of any grade (CTCAE scale) from the signing of consent to D30 (minimum follow-up period for drug research).

Source: https://euclinicaltrials.eu/ctis-public/view/2024-518795-31-00